EU clinical trial 2023-503739-16-00: A Dose Escalation and Cohort Expansion Study of KB-0742 in Participants With Relapsed or Refractory Solid Tumors or Non-Hodgkin Lymphoma.
Protocol code: KB-0742-1001
Sponsor: Kronos Bio Inc. (Pharmaceutical company). Phase: Human Pharmacology (Phase I)- First administration to humans. Countries: Spain (ended), France (ended).
Therapeutic area(s): Not possible to specify
Gender: Female, Male. Age: 18-64 years, 65+ years. Enrolment: 50.
Status: Ended. Start date (EU): 2023-12-20. End date (EU): 2024-11-13. Decision date: 2023-11-17. Results received: No. Last updated: 2024-02-15.
Decision dates by country: FR: 2023-11-20, ES: 2023-11-17

Condition(s): Relapsed or refractory solid tumors or non-Hodgkin lymphoma

Source: https://euclinicaltrials.eu/ctis-public/view/2023-503739-16-00